EU clinical trial 2023-508314-42-00: IMMUWHY - A phase II study of immunotherapy with durvalumab (MEDI4736) or durvalumab and tremelimumab, both combined with Y-90 SIRT therapy in patients with advanced stage intrahepatic biliary tract cancer (BTC) scheduled to receive Y-90 SIRT therapy as standard of care
Protocol code: IMMUWHY
Sponsor: Institut fuer Klinische Krebsforschung IKF GmbH (Pharmaceutical company). Phase: Therapeutic exploratory (Phase II). Countries: Germany (ongoing, recruitment ended), Spain (ongoing, recruitment ended).
Therapeutic area(s): Diseases [C] - Neoplasms [C04]
Gender: Female, Male. Age: 18-64 years, 65+ years. Enrolment: 50.
Status: Ongoing, recruitment ended. Start date (EU): 2020-02-27. Decision date: 2023-11-21. Results received: No. Last updated: 2026-01-19.
Decision dates by country: ES: 2024-05-06, DE: 2023-11-21

Condition(s): Advanced stage intrahepatic biliary tract cancer (BTC)
Product: IMJUDO 20 mg/ml concentrate for solution for infusion., IMFINZI 50 mg/mL concentrate for solution for infusion.

Primary endpoint: Objective response rate (ORR) [according to RECIST 1.1]
Endpoint(s): Safety (rate of adverse events), Duration of response (DoR), Progression free survival (PFS), Overall survival (OS), Exploratory: Predictive biomarkers for ORR, DoR, PFS, OS

Source: https://euclinicaltrials.eu/ctis-public/view/2023-508314-42-00